EU clinical trial 2025-521074-34-00: A phase 2, multicentric study to assess the efficacy and safety of maribavir treatment in hematopoietic stem cell transplant (HSCT) recipients with cytomegalovirus (CMV) infection with a medical condition that contraindicate the administration of ganciclovir, valganciclovir or foscarnet and in those who discontinued first line preemptive therapy with ganciclovir, valganciclovir or foscarnet due to toxicity or intolerance.
Protocol code: MARIBA-GITMO
Sponsor: Gruppo Italiano Per Il Trapianto Di Midollo Osseo Cellule Staminali Emopoietiche E Terapia Cellulare (Patient organisation/association). Phase: Therapeutic exploratory (Phase II). Countries: Italy (ongoing, recruiting).
Therapeutic area(s): Diseases [C] - Hemic and Lymphatic Diseases [C15]; Diseases [C] - Virus Diseases [C02]
Gender: Female, Male. Age: 18-64 years, 65+ years. Enrolment: 81.
Status: Ongoing, recruiting. Start date (EU): 2026-05-15. Decision date: 2025-11-17. Results received: No. Last updated: 2025-11-17.

Condition(s): Allogeneic peripheral hematopoietic stem cell transplant, Cytomegalovirus infection
Product: LIVTENCITY 200 mg film-coated tablets.

Primary endpoint: The primary efficacy end point is the percentage of patients with a response to treatment, defined as plasma CMV DNA level below the lower limit of quantification (confirmed at least in two consecutive tests), at 8 weeks after the start of treatment., The primary safety end point is the incidence of side effects that occurred or worsened during the treatment period and required maribavir therapy discontinuation.
Endpoint(s): The secondary efficacy endpoint is to describe the incidence and frequency of CMV DNAemia detection occurring when patients are on treatment and off treatment up to 8 weeks from the discontinuation of maribavir therapy. The efficacy will be evaluated also according to the CMV infection risk., The secondary endpoint of late response is the proportion of patients with a partial response at 8 weeks of treatment who continued on therapy per investigator’s judgment, with a subsequent response within 12 weeks, defined as CMV DNAaemia below the level of quantification (confirmed in at least two consecutive tests)., The secondary safety endpoint is to describe the incidence of grade > 2 side effects considered related to maribavir therapy during the treatment period.

Source: https://euclinicaltrials.eu/ctis-public/view/2025-521074-34-00